EU clinical trial 2023-504897-39-00: A Phase 1 Study to Determine the Safety, and Pharmacokinetics of the Selective MET kinase Inhibitor, DO-2 in Patients With Advanced or Refractory Solid Tumours
Protocol code: DO2.22.01
Sponsor: Deuteroncology (Pharmaceutical company). Phase: Human Pharmacology (Phase I)- First administration to humans. Countries: Netherlands (ongoing, recruiting), Belgium (ongoing, recruiting), France (ongoing, recruiting).
Therapeutic area(s): Not possible to specify
Gender: Female, Male. Age: 18-64 years, 65+ years. Enrolment: 98.
Status: Ongoing, recruiting. Start date (EU): 2023-04-13. Decision date: 2023-05-31. Results received: No. Last updated: 2025-12-15.
Decision dates by country: FR: 2023-11-13, BE: 2023-06-15, NL: 2023-05-31

Condition(s): Advanced or refractory solid tumours (Part 1), Locally advanced unresectable or metastatic non-small cell lung cancer (NSCLC) (Part 2)

Source: https://euclinicaltrials.eu/ctis-public/view/2023-504897-39-00